EU clinical trial 2023-508166-15-00: Subcutaneous Infliximab After A Previous Intravenous Dose Optimization
Protocol code: BIRD2023001
Sponsor: Belgian IBD Research and Development (Laboratory/Research/Testing facility). Phase: Therapeutic use (Phase IV). Countries: Belgium (ongoing, recruitment ended).
Therapeutic area(s): Diseases [C] - Digestive System Diseases [C06]
Gender: Female, Male. Age: 18-64 years, 65+ years. Enrolment: 275.
Status: Ongoing, recruitment ended. Start date (EU): 2024-04-29. Decision date: 2024-04-09. Results received: No. Last updated: 2025-12-04.

Condition(s): Ulcerative colitis (UC), Inflammatory bowel disease type unclassified (IBDU) and Crohn's disease (CD)
Product: INFLIXIMAB, INFLIXIMAB

Primary endpoint: The proportion of patients that maintain steroid-free clinical and biological remission by week 52 without treatment optimization after switch to subcutaneous infliximab.
Endpoint(s): The proportion of patients that maintain steroid-free clinical and biological remission by week 52 with treatment optimization., The proportion of patients that maintain steroid-free clinical and biological remission by week 52 (with or without treatment optimization)., The proportion of patients that maintain steroid-free clinical and biological remission by week 8, by week 24 (without treatment optimization)., The proportion of patients that maintain steroid-free clinical remission by week 8, by week 24, by week 52 (without treatment optimization)., The proportion of patients that maintain steroid-free biological remission by week 8, by week 24, by week 52 (without treatment optimization)., The proportion of patients switching back to IV infliximab by week 8, by week 24, by week 52., Time to (objectified) clinical relapse (or treatment optimization or treatment discontinuation)., Time to objectified clinical relapse (or treatment optimization or treatment discontinuation)., Time to treatment optimization (or treatment discontinuation)., Time to treatment discontinuation., Time to clinical relapse (patients that undergo treatment optimization or treatment discontinuation without clinical relapse will be regarded as lost to follow-up from that timepoint)., Time to objective clinical relapse (patients that undergo treatment optimization or treatment discontinuation without objective clinical relapse will be regarded as lost to follow-up from that timepoint)., Patients experience and satisfaction with switching to SC therapy by week 8, week 24, by week 52., The proportion of eligible patients willing to switch and effectively switching to SC therapy., Baseline characteristics linked to willingness of switching and effectively switching to SC therapy., Reasons for willing or not willing to switch to SC therapy., Reasons for treatment optimization (clinical disease activity, biological disease activity, endoscopic disease activity, radiological disease activity, and/or other)., Reasons for treatment discontinuation (clinical disease activity, biological disease activity, endoscopic disease activity, radiological disease activity, adverse events, pregnancy, patient's request, and/or other)., The number and type of (serious) adverse events by week 52.

Source: https://euclinicaltrials.eu/ctis-public/view/2023-508166-15-00